EU clinical trial 2023-504984-17-00: A Modular Phase I/IIa, Open-label, Multi-centre Study to Assess the Safety, Tolerability, Pharmacokinetics, Pharmacodynamics and Preliminary Efficacy of Ascending Doses of AZD9574 as Monotherapy and in Combination with Anti-cancer Agents in Patients with Advanced Solid Malignancies
Protocol code: D8410C00001
Sponsor: AstraZeneca AB (Pharmaceutical company). Phase: Phase I and Phase II (Integrated)- First administration to humans. Countries: Sweden (ongoing, recruiting), Spain (ongoing, recruiting).
Therapeutic area(s): Diseases [C] - Neoplasms [C04]
Gender: Female, Male. Age: 18-64 years, 65+ years. Enrolment: 176.
Status: Ongoing, recruiting. Start date (EU): 2022-10-05. Decision date: 2024-06-24. Results received: No. Last updated: 2026-06-03.
Decision dates by country: SE: 2024-06-24, ES: 2024-06-25

Condition(s): Module 3: advanced/relapsed HER2-negative breast, ovarian, prostate, or pancreatic cancer and expressing BRCA1m, BRCA2m, PALB2m, RAD51Cm or RAD51Dm, IDH-mutant recurrent glioma, breast cancer (without BM), Module 1: advanced/relapsed ovarian, breast, pancreatic or prostate cancer where patients loss of function or predicted loss of function mutation in BRCA1, BRCA2, PALB2, RAD51C, or RAD51D, Module 4: advanced,unresectable and HER2+ metastatic solid tumours; NSCLC, HER2 activating mutation, Module 5: advanced,unresectable or metastatic solid tumours in breast, endometrial, ovarian and prostate cancer, Module 2: IDH-mutant glioma
Product: AZD9574, TEMOZO-cell® 20 mg Hartkapseln, AZD9574, AZD9574, TEMOZO-cell® 5 mg Hartkapseln, TEMOZO-cell® 180 mg Hartkapseln, AZD9574, Datopotamab deruxtecan, TEMOZO-cell ®250 mg Hartkapseln, AZD9574, TEMOZO-cell® 100 mg Hartkapseln, TEMOZO-cell® 140 mg Hartkapseln, DS-8201a

Primary endpoint: Incidence of AEs/SAEs; DLTs; MTD; Changes from baseline in laboratory findings, ECOG PS, ECGs and vital signs.
Endpoint(s): Plasma concentrations of AZD9574 and plasma PK parameters including but not limited to • Area under the curve after a single dose and after multiple doses • Maximum plasma concentration after a single dose and after multiple doses • Time to reach maximum plasma concentration • Minimum plasma concentration at steady state • Half-life • Accumulation ratio • Dose proportionality, Module 1: Assessment of pH2AX PD biomarker modulations at baseline and during treatment or pre-treatment in PD biomarkers, Module 1: Radiological response evaluated according to response evaluation criteria in solid tumours (RECIST v1.1) − Percentage change in target lesion size − ORR, DoR, TTR, PFS/rPFS. For ovarian cancer participants: CA125 response evaluated according to the GCIG criteria., Module 1: For prostate cancer participants: • Proportion of participants achieving a ≥ 50% decrease in PSA from baseline to the lowest post-baseline PSA result, confirmed by a second consecutive PSA assessment at least 3 weeks later (PSA50 response) • Radiological response evaluated according to RECIST v1.1 + PCWG3 response evaluation criteria, Module 1: PK parameters, including but not limited to AUC and/or AUC(0-t), Cmax, Tmax, AUC(0-t) and Cmax ratio, with and without a high fat meal., Module 1: PK parameters, including but not limited to AUC and/or AUC(0-t), Cmax, Tmax, AUC(0-t) and Cmax ratio, with and without famotidine., Module 2: Radiological response evaluated according to RANO-HGG or RANO-LGG • Percentage change in target lesions size • ORR, DoR, TTR, PFS, Module 3: Plasma concentrations of AZD9574 and plasma PK parameters including but not limited to • Area under the curve (AUC) after a single dose and after multiple doses • Maximum plasma concentration (Cmax) after a single dose and after multiple doses • Time to reach maximum plasma concentration (tmax) • Minimum plasma concentration at steady state (Cmin,ss) • Half-life (t1/2) • Accumulation ratio, Module 3: Difference in radioligand binding to PARP1 from baseline to study intervention administration (occupancy [%]), Module 3: Radiological response evaluated according to RECIST v1.1 − Percentage change in target lesion size − ORR, DoR, TTR, PFS/rPFS • For ovarian cancer participants: CA125 response evaluated according to the GCIG criteria, Module 3: For prostate cancer participants: − Participants achieving a ≥ 50% decrease in PSA from baseline to the lowest post baseline PSA result, confirmed by a second consecutive PSA assessment at least 3 weeks later (PSA50 response) − Radiological response evaluated according to RECIST v1.1 (soft tissue) + PCWG3 (bone) response evaluation criteria, Module 3: Radiological response evaluated according to RANO-HGG or RANO-LGG • Percentage change in target lesions size • ORR, DoR, TTR, PFS, Module 4: Measurement of plasma concentrations AZD9574 and serum concentrations of T-DXd after administration of a single dose and multiple doses; and derivation of the following PK parameters including, but not limited to (as data allow): • AUC • Cmax • Tmax, Module 4: Assessment of modulation from baseline (Visit 1) or pre-treatment in PD biomarkers from (optional) tumour samples; including, but not limited to assessment of pH2AX (Ser139), Module 4: Presence of ADAs for T-DXd, Module 4: Incidence of: • ILD/pneumonitis • LVEF • ≥ Grade 3 Neutropenia (Part B only), Module 4: Radiological response evaluated according to response evaluation criteria in solid tumours (RECIST v1.1) percentage change in target lesion size • ORR, DoR, PFS, TTR • Where appropriate, tumour marker response data will be summarized depending on the cancer type, eg, CA125 for ovarian cancer • PFS6 (Part B only), Module 5: Measurement of plasma concentrations of AZD9574 and Dato-DXd after a single dose and multiple doses; and derivation of the following PK parameters, including, but not limited to (as data allow): − AUC − Cmax − Tmax, Module 5: Assessment of modulation from baseline (Visit 1) or pre-treatment in PD biomarkers from (optional) tumour samples; includes, but is not limited to assessment of pH2AX (Ser139), Module 5: Presence of ADAs for Dato-DXd, Module 5: Radiological response evaluated according to response evaluation criteria in solid tumours (RECIST v1.1) − percentage change in target lesion size − ORR, DoR, PFS, TTR • Where appropriate, tumour marker response data will be summarized depending on the cancer type, eg, CA125 for ovarian cancer., Module 5 : • For participants with prostate cancer: − ORR and rPFS according to RECIST v1.1 (soft tissue) + PCWG3 (bone) response evaluation criteria − Proportion of patients achieving a ≥ 50% decrease in PSA from baseline to the post-baseline PSA result, confirmed by a second consecutive PSA assessment at least 3 weeks later (PSA50 response), Module 5: Incidence of: • Interstitial Lung Disease/Pneumonitis • Infusion-related Reactions • Oral Mucositis/Stomatitis • Mucosal Inflammation Other than Oral Mucositis/Stomatitis • Ocular Surface Events

Source: https://euclinicaltrials.eu/ctis-public/view/2023-504984-17-00